EU clinical trial 2022-501809-13-01: Experimental Study on Alcohol Use and Behavior in Young Adults
Sponsor: Karolinska Institutet (Educational Institution). Phase: Therapeutic exploratory (Phase II). Countries: Sweden (ended).
Therapeutic area(s): Psychiatry and Psychology [F] - Behavior and Behavior Mechanisms [F01]
Gender: Male. Age: 18-64 years. Enrolment: 220.
Status: Ended. End date (EU): 2025-04-23. Decision date: 2023-05-17. Results received: No. Last updated: 2023-12-19.

Condition(s): Alcohol Use Disorder (AUD)
Product: Renässans Naturell Nässpray, Syntocinon 6,7 mikrogram/dos nässpray, lösning

Primary endpoint: Prosocial behavior using a dictator game task measured at both study visits 35-75 minutes after administration of the investigational medicinal product.
Endpoint(s): Impulsivity using a delay discounting task, emotion recognition using an emotion recognition task, social learning using an observational fear learning task, and alcohol craving using an alcohol cue-craving task measured at both visits 76-120 minutes after administration of the investigational medicinal product.

Source: https://euclinicaltrials.eu/ctis-public/view/2022-501809-13-01